EU clinical trial 2025-521740-38-00: A Phase I/II, randomized, placebo-controlled, multi-arm, dose-finding study to evaluate the safety, efficacy and immunogenicity of an Acne mRNA vaccine candidate in adults with moderate to severe acne 18 to 45 years of age
Protocol code: VBE00001
Sponsor: Sanofi Pasteur Inc. (Pharmaceutical company). Phase: Phase I and Phase II (Integrated)- First administration to humans. Countries: Spain (authorised, recruitment pending), Germany (authorised, recruitment pending), Poland (authorised, recruitment pending).
Therapeutic area(s): Diseases [C] - Skin and Connective Tissue Diseases [C17]
Gender: Female, Male. Age: 18-64 years. Enrolment: 189.
Status: Authorised, recruitment pending. Decision date: 2026-07-29. Results received: No. Last updated: 2026-07-31.
Decision dates by country: ES: 2026-07-31, PL: 2026-07-29, DE: 2026-07-31

Condition(s): Acne
Product: Acne mRNA vaccine, Diluent : 0,9% sodium chloride solution

Primary endpoint: Core Study - Sentinel Cohorts A and B: Number of participants with unsolicited systemic AEs, Core Study - Sentinel Cohorts A and B: Number of participants with solicited injection site and systemic reactions, Core Study - Sentinel Cohorts A and B: Number of participants with unsolicited AEs, Core Study - Sentinel Cohorts A and B: Number of participants with MAAEs, Core Study - Sentinel Cohorts A and B: Number of patients with SAEs, Core Study - Sentinel Cohorts A and B: Number of participants with AESIs, Core Study - Sentinel Cohorts A and B: Number of participants with out-of-range biological test results (including shift from baseline values), Core Study - Main Cohort A: Percentage change from baseline (Day 1) in the number of inflammatory acne lesions on face, Core Study - Main Cohort A: Percentage change from baseline (Day 1) in the number of non-inflammatory acne lesions on face, Core Study – Main Cohort B: Percentage change from baseline (Day 1) in the total number of acne lesions on face at, Long-Term Extension – Sentinel Cohorts A, B and Main Cohort: Number of participants with SAEs and AESIs
Endpoint(s): Core Study - Sentinel Cohorts A, B and Main Cohorts A and B: Assessment of vaccine-antigen-specific serum antibody titers, Core Study - Main Cohort A and B: Absolute and percentage change from baseline (Day 1) in the total number of acne lesions on face, Core Study - Main Cohorts A and B: Absolute and percentage change from baseline (Day 1) in the number of inflammatory acne lesions on face, Core Study - Main Cohorts A and B: Absolute change from baseline (Day 1) in the number of non-inflammatory acne lesions on face, Core Study - Main Cohorts: Absolute change from baseline in IGA score, Core Study - Main Cohorts A and B: Number of participants with unsolicited systemic AEs, Core Study - Main Cohorts A and B: Number of participants with solicited injection site and systemic reactions, Core Study - Main Cohorts A and B: Number of participants with unsolicited AEs, Core Study - Main Cohorts A and B: Number of participants with MAAEs, Core Study - Main Cohorts A and B: Number of participants with SAEs, Core Study - Main Cohorts A and B: Number of participants with AESIs, Cores Study - Main Cohorts A and B: Number of participants with out-of-range biological test results (including shift from baseline values)

Source: https://euclinicaltrials.eu/ctis-public/view/2025-521740-38-00